EU clinical trial 2025-521628-31-00: A Phase 3 Randomized, Double-Blind, Placebo-Controlled, Multicenter Study to Evaluate the Efficacy and Safety of Subcutaneous Nomlabofusp in Subjects with Friedreich’s Ataxia
Protocol code: CLIN-1601-301
Sponsor: Larimar Therapeutics Inc. (Pharmaceutical company). Phase: Therapeutic confirmatory (Phase III). Countries: France (authorised, recruitment pending).
Therapeutic area(s): Diseases [C] - Nervous System Diseases [C10]
Gender: Female, Male. Age: 0-17 years, 18-64 years. Enrolment: 18.
Status: Authorised, recruitment pending. Decision date: 2026-04-16. Results received: No. Last updated: 2026-04-28.

Condition(s): Friedreich’s ataxia is the most common inherited ataxia in humans and results from a deficiency of the mitochondrial protein, FXN. Friedreich’s ataxia is a rare, progressive, multisystem disease with an incidence that is estimated to be 1:29,000, and a carrier frequency of ~1:85.
Product: Nomlabofusp, Placebo to Nomlabofusp

Primary endpoint: PRIMARY: • Difference between participant groups (see Study Design Section) on the Modified Friedreich’s Ataxia Rating Scale (mFARS) total score at study Week 72 compared with baseline
Endpoint(s): SECONDARY: • Difference between participant groups in Clinical Global Impression of Severity (CGI-S) score at study Week 72 compared with baseline, SECONDARY: • Differences between participant groups in scores on physical function tests (Upright Stability Score (USS) Subscale E of the mFARS, 9-hole peg test, and 25-foot walk test) at study Week 72 compared with baseline, SECONDARY: • Differences between participant groups in scores on 1) the Friedreich’s Ataxia Rating Scale – Activities of Daily Living and 2) the fatigue numeric rating scale at study Week 72 compared with baseline, SECONDARY: • Differences between participant groups in left ventricular mass index, measured on echocardiogram, at study Week 72 compared with baseline, SECONDARY: • Differences between participant groups in changes over time in frataxin amount measured in the skin and in the inside of the cheek, SAFETY: • Incidence of side effects and serious side effects happening after receiving nomlabofusp, monitored for the entire study duration, IMMUNOGENICITY: • Incidence of antidrug antibodies (proteins that cause the immune system to fight the drug) throughout the study

Source: https://euclinicaltrials.eu/ctis-public/view/2025-521628-31-00